EU clinical trial 2024-516288-10-00: An Open-label Phase 1/2 Multicentre Study to Evaluate the Safety, Tolerability and Efficacy of RTX001 Autologous Macrophages in Participants with Liver Cirrhosis who have Hepatic Decompensation (EMERALD)
Protocol code: RTX001-002
Sponsor: Resolution Therapeutics Limited (Pharmaceutical company). Phase: Phase I and Phase II (Integrated)- Other. Countries: Spain (ongoing, recruitment ended).
Therapeutic area(s): Diseases [C] - Digestive System Diseases [C06]
Gender: Female, Male. Age: 18-64 years, 65+ years. Enrolment: 8.
Status: Ongoing, recruitment ended. Start date (EU): 2025-03-21. Decision date: 2024-11-11. Results received: No. Last updated: 2026-03-25.

Condition(s): Liver Cirrhosis
Product: RTX001, Neupogen 30 MU (0,6 mg/ml) solución inyectable en jeringa precargada filgrastim, Neupogen 48 MU (0,96 mg/ml) solución inyectable en jeringa precargada filgrastim

Primary endpoint: 1. Incidence and severity of TEAEs and SAEs, 2. Changes from baseline in safety assessments, 3. Incidence and severity of infusion reactions
Endpoint(s): Time-to, incidence and severity of: 1. Development of a second portal hypertension-driven decompensating event (ascites, variceal haemorrhage or hepatic encephalopathy)., 2. Development of recurrent variceal bleeding, recurrent ascites (requirement of ≥3 large-volume paracenteses within 1 year), recurrent encephalopathy, development of SBP and/or HRS-AKI, 3. In participants presenting with bleeding alone, development of ascites, or encephalopathy, after recovery from bleeding (but not if these events occur around the time of bleeding), 4. All hepatic decompensation events including SBP and/or HRS-AKI, new listing for liver transplantation or liver transplantation, 5. Mortality (hepatic related and all-cause), transplant-free survival., 6. ΔMELD, ΔΔMELD and MELD stabilisation

Source: https://euclinicaltrials.eu/ctis-public/view/2024-516288-10-00